EU clinical trial 2024-512543-23-00: RECOMPENSE: Right vEntricular COMPENsation with SotatercEpt. A prospective single arm open label phase IV study to evaluate the effects of sotatercept on right ventricular function in pulmonary arterial hypertension
Protocol code: 2024-512543-23-00
Sponsor: Amsterdam UMC Stichting (Hospital/Clinic/Other health care facility). Phase: Therapeutic use (Phase IV). Countries: Netherlands (authorised, recruiting).
Therapeutic area(s): Diseases [C] - Cardiovascular Diseases [C14]
Gender: Female, Male. Age: 18-64 years. Enrolment: 20.
Status: Authorised, recruiting. Start date (EU): 2025-05-14. Decision date: 2025-04-14. Results received: No. Last updated: 2026-01-29.

Condition(s): Pulmonary arterial hypertension
Product: Winrevair 60 mg powder for solution for injection

Primary endpoint: Change in power per beat after 24 weeks of sotatercept, Change in right ventricular pulmonary artery coupling index (Ees/Ea) after 24 weeks of sotatercept
Endpoint(s): ∆ Right Ventricular End Diastolic Volume (RVEDV), ∆ Right Ventricular End Systolic Volume (RVESV), ∆ Right Ventricular Ejection Fraction (RVEF), ∆ Right Ventricular mass, ∆ Stroke Volume determined from aortic flow, ∆ Left Ventricular End Diastolic Volume (LVEDV), ∆ Left Ventricular End Systolic Volume (LVESV), ∆ Left Ventricular Ejection Fraction (LVEF), ∆ Left ventricular mass, ∆ End-systolic elastance (Ees), ∆ Arterial elastance (Ea), ∆ End diastolic elastance (Eed), ∆ Extracellular volume as measured by cardiac magnetic resonance imaging

Source: https://euclinicaltrials.eu/ctis-public/view/2024-512543-23-00